EU clinical trial 2024-518071-58-00: A Phase 1b Open-Label Study to Evaluate the Safety and Tolerability of Eganelisib as Monotherapy and in Combination with Cytarabine in Patients with Relapsed/Refractory Acute Myeloid Leukemia
Protocol code: STLX-EGA-001
Sponsor: Stelexis Biosciences Inc. (Pharmaceutical company). Phase: Phase I and Phase II (Integrated)- Other. Countries: Spain (ongoing, recruiting).
Therapeutic area(s): Diseases [C] - Hemic and Lymphatic Diseases [C15]
Gender: Female, Male. Age: 18-64 years, 65+ years. Enrolment: 19.
Status: Ongoing, recruiting. Start date (EU): 2025-05-16. Decision date: 2025-04-11. Results received: No. Last updated: 2026-03-05.

Condition(s): Relapsed/refractory (r/r) acute myeloid leukemia (AML) or r/r higher-risk myelodysplastic syndromes (HR-MDS)
Product: Eganelisib 30mg Capsules, Cytarabine 20 mg/ml Injection, Eganelisib 5mg Capsules

Primary endpoint: Part 1 – Monotherapy and Combination Dose Escalation (DE): Incidence and severity of adverse events (AEs), graded according to the National Cancer Institute Common Terminology Criteria for Adverse Events (NCI CTCAE), Version 5.0, Part 1 – Monotherapy and Combination Dose Escalation (DE): Incidence and severity of dose-limiting toxicities (DLTs) in DLT-evaluable patients during Cycle 1, Part 2 – Dose Optimization (OPT): AML: per ELN 2022 criteria CR rate, Part 2 – Dose Optimization (OPT): HR-MDS: per IWG 2023 criteria CR rate, defined as CR + CR equivalent
Endpoint(s): Part 1 – Monotherapy and Combination Dose Escalation (DE): AML: per European LeukemiaNet (ELN) 2022 criteria (Dohner et al., 2022); Complete response [CR] rate; Composite CR (CR + CRh); Composite CRMRD- (CRMRD- + CRhMRD-); ORR (CR + CRi + CRh + partial response [PR] + morphologic leukemia-free status [MLFS]); Duration of response; Time to CR, time to composite CRs; Transfusion-independence (TI); Duration of TI, Part 1 – Monotherapy and Combination Dose Escalation (DE): HR-MDS: per International Working Group (IWG) 2023 criteria (Zeidan et al., 2023); CR rate, defined as CR + CR equivalent; ORR (CR + CR equivalent + CRh + CRL + PR + hematologic improvement [HI]); Duration of response; Time to CR; TI; Duration of TI, Part 1 – Monotherapy and Combination Dose Escalation (DE): Both AML and HR-MDS: Frequency of transition to allogeneic hematopoietic stem cell transplant (HSCT); Early death rate; Event-free survival (EFS); Overall survival (OS), Part 1 – Monotherapy and Combination Dose Escalation (DE): Noncompartmental PK parameters of eganelisib (eg, area-under-the-curve [AUC0-24h, AUC0-͚∞], maximum concentration [Cmax], time of Cmax [Tmax], half-life [t1/2]), Part 1 – Combination Dose Escalation (DE): Noncompartmental PK parameters of cytarabine (eg, Cmax, Tmax, AUC, possibly t1/2, volume of distribution [Vd], and clearance [CL]), Part 2 – Dose Optimization (OPT): Incidence and severity of AEs, graded according to the NCI CTCAE, Version 5.0, Part 2 – Dose Optimization (OPT): AML: per ELN 2022 criteria: Composite CR (CR + CRh); Composite CRMRD- (CRMRD- + CRhMRD-); ORR (CR + CRi + CRh + PR + MLFS); Duration of response; Time to CR: time to composite CRs; TI; Duration of TI, Part 2 – Dose Optimization (OPT): HR-MDS: per IWG 2023 criteria: ORR (CR + CR equivalent + CRh + CRL + PR + HI); Duration of response; Time to CR; TI; Duration of TI, Part 2 Dose Optimization (OPT): Both AML and HR-MDS; Frequency of transition to allogeneic HSCT; Early death rate; EFS; OS, Part 2 Dose Optimization (OPT): Plasma concentrations and population pharmacokinetic (PopPK) assessment of possible covariates of exposure, safety, and efficacy

Source: https://euclinicaltrials.eu/ctis-public/view/2024-518071-58-00